EU clinical trial 2024-520253-21-00: The Chronic Kidney Disease Adaptive Platform Trial Investigating Various Agents for Therapeutic Effect (CAPTIVATE)
Protocol code: P01351
Sponsor: The George Institute For Global Health (Laboratory/Research/Testing facility). Phase: Therapeutic confirmatory (Phase III). Countries: Spain (ongoing, recruiting), Greece (authorised, recruitment pending).
Therapeutic area(s): Diseases [C] - Nutritional and Metabolic Diseases [C18]
Gender: Female, Male. Age: 18-64 years, 65+ years. Enrolment: 250.
Start date (EU): 2026-02-02. Decision date: 2025-06-06. Results received: No. Last updated: 2026-07-20.
Decision dates by country: GR: 2026-04-09, ES: 2025-06-06

Condition(s): Chronic Kidney Disease
Product: Placebo coated tablet 002 to bay 948862 coated tablet, Kerendia 20 mg film-coated tablets, Kerendia 10 mg film coated tablets

Primary endpoint: Chronic eGFR slope estimated from all available eGFR values from week 4 to week 104
Endpoint(s): Change in albuminuria as measured by uACR (or uPCR if uACR unavailable) between randomisation and 24 weeks, measured as a continuous variable, Composite outcome of proportion of participants experiencing a ≥40% eGFR decline between randomisation and 108 weeks, and proportion of participants developing kidney failure (defined as eGFR <15 mL/min/1.73m^2 or chronic kidney replacement therapy start) at 108 weeks, Time to a composite outcome of ≥40% eGFR decline from randomisation or kidney failure, All-cause mortality at 108 weeks, Proportion of participants experiencing one or more cardiovascular events (cardiovascular death, hospitalised heart failure, myocardial infarction, stroke) between randomisation and 108 weeks, Time to first occurrence of a cardiovascular event, Safety and tolerability of treatment, Change in quality of life measured using the Quality of Life Impact Survey for Kidney Disease (QDIS-CKD) at 6-monthly intervals from randomisation to week 108, The Mineralocorticoid Receptor Antagonist Domain-Specific Appendix has a domain-specific secondary outcome of time to the composite of ≥57% eGFR decline or kidney failure, Change in eGFR from randomisation to end of washout

Source: https://euclinicaltrials.eu/ctis-public/view/2024-520253-21-00